EU clinical trial 2022-502756-31-00: LOXO-RAS-20001; A Phase 1a/1b Study of LY3537982 in Patients with KRAS G12C-Mutant Advanced Solid Tumors
Protocol code: LOXO-RAS-20001
Sponsor: Eli Lilly & Co. (Pharmaceutical company). Phase: Phase I and Phase II (Integrated)- First administration to humans. Countries: France (ongoing, recruiting).
Therapeutic area(s): Diseases [C] - Neoplasms [C04]
Gender: Female, Male. Age: 18-64 years, 65+ years. Enrolment: 200.
Status: Ongoing, recruiting. Start date (EU): 2022-07-20. Decision date: 2024-10-07. Results received: No. Last updated: 2026-06-08.

Condition(s): KRAS G12C-Mutant Advanced Solid Tumors
Product: olomorasib, KEYTRUDA 25 mg/mL concentrate for solution for infusion, CETUXIMAB

Primary endpoint: Dose limiting toxicity (DLT) rate and DLT-equivalent toxicities, Rates of TEAEs, SAEs, deaths, and clinical laboratory abnormalities, Antitumor activity of LY3537982
Endpoint(s): ORR, BOR, DOR, TTR, DCR, PFS, OS, Intracranial ORR and DOR, Plasma concentration of LY3537982 as moontherapy and when administered in combination: PK parameters including, but not limited ot, AUC, Cmax, Tmax, and degree of accumulation

Source: https://euclinicaltrials.eu/ctis-public/view/2022-502756-31-00